EU clinical trial 2023-509447-28-00: A study to learn about the amount of asundexian in the blood when healthy participants take different types of asundexian tablets
Protocol code: 22665
Sponsor: Bayer AG (Pharmaceutical company). Phase: Human Pharmacology (Phase I)- Other. Countries: Germany (ended).
Therapeutic area(s): Diseases [C] - Cardiovascular Diseases [C14]
Gender: Female, Male. Age: 18-64 years. Enrolment: 16.
Status: Ended. Start date (EU): 2024-07-26. End date (EU): 2024-10-29. Decision date: 2024-05-17. Results received: No. Last updated: 2024-05-17.

Condition(s): Prevention of ischemic stroke in patients post acute non-cardioembolic ischemic stroke or high-risk transient ischemic attack

Source: https://euclinicaltrials.eu/ctis-public/view/2023-509447-28-00